EU clinical trial 2023-507429-41-00: Multicenter, randomized, double-blind, controlled clinical trial to evaluate the safety and efficacy of PRGF-Endoret® infiltrations in the treatment of low back pain
Protocol code: BTIIMD-03-EC-23-DISC
Sponsor: Biotechnology Institue I Mas D S.L. (Pharmaceutical company). Phase: Therapeutic use (Phase IV). Countries: Spain (ongoing, recruiting).
Therapeutic area(s): Diseases [C] - Musculoskeletal Diseases [C05]
Gender: Female, Male. Age: 18-64 years, 65+ years. Enrolment: 48.
Status: Ongoing, recruiting. Start date (EU): 2024-12-26. Decision date: 2024-09-10. Results received: No. Last updated: 2026-03-31.

Condition(s): Low back pain
Product: Celestone Cronodose suspensión inyectable, Plasma rich in growth factors

Primary endpoint: Evaluation of the Oswestry scale at 6 months follow-up.
Endpoint(s): Percentage of treatment failures at 1, 3, and 12 months follow-up (following the definition in 8.7)., Assessment of the Oswestry scale at 1, 3, and 12 months of follow-up., Evaluation of the COMI scale at 1, 3, 6, and 12 months of follow-up., Evaluation of the SF-12 scale at 1, 3, 6, and 12 months of follow-up., Radiological imaging (MRI) results. Differences at 12 months with respect to baseline determinations of the: Pfirrmann, Size of the disc herniation, Intervertebral space height (endplate to endplate) and Disc volume grade., Incidence and type of adverse events., Cost-utility analysis., Hematological characterization of blood and PRGF., Biochemical characterization of PRGF.

Source: https://euclinicaltrials.eu/ctis-public/view/2023-507429-41-00